EU clinical trial 2024-514294-22-01: Neoadjuvant chemotherapy versus standard treatment in patients with locally advanced colon cancer (NeoCol)
Protocol code: NeoCol
Sponsor: Lillebaelt Hospital (Hospital/Clinic/Other health care facility). Phase: Therapeutic confirmatory (Phase III). Countries: Norway (ongoing, recruitment ended), Denmark (ongoing, recruitment ended).
Therapeutic area(s): Diseases [C] - Neoplasms [C04]
Gender: Female, Male. Age: 18-64 years, 65+ years. Enrolment: 247.
Status: Ongoing, recruitment ended. Start date (EU): 2013-10-14. Decision date: 2024-09-27. Results received: No. Last updated: 2024-10-02.
Decision dates by country: NO: 2024-10-02, DK: 2024-09-27

Condition(s): Colon cancer
Product: CAPECITABINE, OXALIPLATIN

Primary endpoint: Two-year disease free survival

Source: https://euclinicaltrials.eu/ctis-public/view/2024-514294-22-01